EU clinical trial 2024-510969-42-00: A Phase 2 Study to Evaluate the Pharmacokinetics, Efficacy, and Safety of Subcutaneous Pembrolizumab Coformulated With Hyaluronidase (MK-3475A) in Participants with Relapsed or Refractory Classical Hodgkin Lymphoma (rrcHL) or Relapsed or Refractory Primary Mediastinal Large B-cell Lymphoma (rrPMBCL)
Protocol code: MK-3475A-F65
Sponsor: Merck Sharp & Dohme LLC (Pharmaceutical company). Phase: Therapeutic exploratory (Phase II). Countries: Poland (ongoing, recruitment ended), Spain (ongoing, recruitment ended), Germany (ongoing, recruitment ended).
Therapeutic area(s): Diseases [C] - Neoplasms [C04]
Gender: Female, Male. Age: 18-64 years, 65+ years. Enrolment: 30.
Status: Ongoing, recruitment ended. Start date (EU): 2024-09-30. Decision date: 2024-09-16. Results received: No. Last updated: 2026-05-04.
Decision dates by country: PL: 2024-09-22, DE: 2024-12-17, ES: 2024-09-16

Condition(s): Relapsed or Refractory Classical Hodgkin’s Lymphoma (rrcHL) or Relapsed or Refractory Primary Mediastinal Large B-cell Lymphoma (rrPMBCL)
Product: MK-3475A

Primary endpoint: Maximum Concentration (Cmax) of Pembrolizumab After Administration of SC Pembrolizumab Coformulated with Hyaluronidase, Lowest Plasma Concentration (Ctrough) of Pembrolizumab After Administration of SC Pembrolizumab Coformulated with Hyaluronidase, Area Under the Concentration-Time Curve of Pembrolizumab After Administration of SC Pembrolizumab Coformulated with Hyaluronidase from Week 0-Week 6 (AUC0-6weeks), Objective Response Rate (ORR) per Lugano Classification Criteria as Assessed by Investigator
Endpoint(s): Maximum Concentration (Cmax) of Pembrolizumab After Administration of SC Pembrolizumab Coformulated with Hyaluronidase at Steady-State, Lowest Plasma Concentration (Ctrough) of Pembrolizumab After Administration of SC Pembrolizumab Coformulated with Hyaluronidase at Steady-State, Area Under the Concentration-Time Curve of Pembrolizumab After Administration of SC Pembrolizumab Coformulated with Hyaluronidase from Week 0-Week 6 (AUC0-6weeks) at Steady-State, Number of Participants with Antidrug Antibodies (ADA) Level of Pembrolizumab After Administration of SC Pembrolizumab Coformulated with Hyaluronidase, Number of Participants Experiencing an Adverse Event (AE), Number of Participants Discontinuing Study Treatment due to an Adverse Event (AE), Duration of Response (DOR) per Lugano Classification Criteria as Assessed by Investigator

Source: https://euclinicaltrials.eu/ctis-public/view/2024-510969-42-00